EU clinical trial 2023-508703-21-00: A Phase 1/2 Study to Evaluate the Safety and Efficacy of MK-2870 Monotherapy or in Combination With Other Anticancer Agents in Gastrointestinal Cancers
Protocol code: MK-9999-02A
Sponsor: Merck Sharp & Dohme LLC (Pharmaceutical company). Phase: Phase I and Phase II (Integrated)- Other. Countries: Italy (ongoing, recruiting), Spain (ongoing, recruiting).
Therapeutic area(s): Diseases [C] - Neoplasms [C04]
Gender: Female, Male. Age: 18-64 years, 65+ years. Enrolment: 20.
Status: Ongoing, recruiting. Start date (EU): 2024-08-01. Decision date: 2024-07-08. Results received: No. Last updated: 2026-05-22.
Decision dates by country: IT: 2024-07-11, ES: 2024-07-08

Condition(s): Colorectal cancer (CRC), pancreatic ductal adenocarcinoma (PDAC), biliary tract cancer (BTC)
Product: KEYTRUDA 25 mg/mL concentrate for solution for infusion., PARACETAMOL, CISPLATIN, FLUOROURACIL, MK-2870, CALCIUM FOLINATE, CALCIUM LEVOFOLINATE, MK-2870

Primary endpoint: 1. Number of Participants Who Experience a Dose-limiting Toxicity (DLT), 2. Number of Participants Who Experience One or More Adverse Events (AEs), 3. Number of Participants Who Discontinue Study Treatment Due to an AE, 4. Objective Response Rate (ORR) per Response Evaluation Criteria in Solid Tumors (RECIST) 1.1 as Assessed by Blinded Independent Central Review (BICR)
Endpoint(s): 1. Duration of Response (DOR) per RECIST 1.1 as Assessed by BICR, 2. Progression-free Survival (PFS) per RECIST 1.1 as Assessed by BICR, 3. Overall Survival (OS)

Source: https://euclinicaltrials.eu/ctis-public/view/2023-508703-21-00